EU clinical trial 2023-510346-25-00: A Randomized, Double-blind, Placebo-controlled Study to Investigate the Efficacy and Safety of Depemokimab in Adults with Hypereosinophilic Syndrome (HES)
Protocol code: 217013
Sponsor: Glaxosmithkline Research & Development Limited (Pharmaceutical company). Phase: Therapeutic confirmatory (Phase III). Countries: Belgium (ended), Romania (ongoing, recruiting), Spain (ongoing, recruiting), Germany (ongoing, recruiting), Poland (ongoing, recruiting), Denmark (authorised, recruiting), Italy (ongoing, recruiting), Czechia (ongoing, recruiting), Greece (authorised, recruiting).
Therapeutic area(s): Diseases [C] - Hemic and Lymphatic Diseases [C15]
Gender: Female, Male. Age: 18-64 years, 65+ years. Enrolment: 36.
Start date (EU): 2022-09-01. Decision date: 2024-08-01. Results received: No. Last updated: 2026-07-20.
Decision dates by country: BE: 2024-08-01, DE: 2024-08-07, IT: 2024-08-05, GR: 2024-10-23, RO: 2024-08-02, DK: 2024-08-05, PL: 2024-08-04, CZ: 2024-08-01, ES: 2024-08-02

Condition(s): Hypereosinophilic Syndrome (HES)
Product: Placebo for Prednisolone, PREDNISOLONE, Placebo for Depemokimab Injection

Primary endpoint: Frequency of HES flares during the 52-week study intervention period
Endpoint(s): Time to first HES flare (days), At least one HES flare during the 52-week study intervention period, Change from Baseline to Week 52 in Brief Fatigue Inventory (BFI) item 3 weekly average score., Change from Baseline to Week 24 in Patient Reported Outcomes Measurement Information System (PROMIS) Fatigue Short Form (SF) 7a score

Source: https://euclinicaltrials.eu/ctis-public/view/2023-510346-25-00